EU clinical trial 2023-503582-35-00: Staphylococcus aureus Network Adaptive Platform trial (SNAP)
Sponsor: University Medical Center Utrecht (Hospital/Clinic/Other health care facility). Phase: Therapeutic use (Phase IV). Countries: Netherlands (ongoing, recruiting), Germany (ongoing, recruiting), Sweden (ongoing, recruiting), France (ongoing, recruiting).
Therapeutic area(s): Diseases [C] - Bacterial Infections and Mycoses [C01]
Gender: Female, Male. Age: 18-64 years, 65+ years. Enrolment: 2348.
Status: Ongoing, recruiting. Start date (EU): 2023-10-26. Decision date: 2023-08-03. Results received: No. Last updated: 2026-05-06.
Decision dates by country: SE: 2024-07-08, FR: 2026-01-08, NL: 2023-08-03, DE: 2024-07-15

Condition(s): Staphylococcus aureus bacteremia
Product: FLUCLOXACILLIN, BENZYLPENICILLIN SODIUM, DAPTOMYCIN, DOXYCYCLINE, MOXIFLOXACIN, VANCOMYCIN, CEFALEXIN, AMOXICILLIN, RIFAMPICIN, CO-TRIMOXAZOLE, LEVOFLOXACIN, LINEZOLID, CLINDAMYCIN HYDROCHLORIDE, CLINDAMYCIN, CEFAZOLIN

Primary endpoint: all-cause mortality at 90 days after platform entry
Endpoint(s): All-cause mortality at 14, 28 and 42 days after platform entry, Duration of survival censored at 90 days after platform entry, Length of stay of acute index inpatient hospitalisation for those surviving until discharge from acute inpatient facilities (excluding HITH/COPAT/OPAT/rehab), measured from platform entry to discharge from acute inpatient facilities, truncated at 90 days after platform entry., Length of stay of total index hospitalisation for those surviving until hospital discharge (including HITH/COPAT/OPAT/rehab), measured from platform entry to discharge from total index hospitalisation, truncated at 90 days after platform entry., Time to being discharged alive from the total index hospitalisation (including HITH/COPAT/OPAT/rehab), measured from platform entry to discharge from total index hospitalisation, truncated at 90 days after platform entry (and all deaths within 90 days will be considered ’90 days’)., Microbiological treatment failure defined as positive sterile site culture for S. aureus [of the same silo as the index isolate] between 14 and 90 days after platform entry). A sterile site means any sites deep to the skin and skin structures, including deep visceral and musculoskeletal abscesses that have been obtained in a sterile manner., Diagnosis of new foci between 14 and 90 days after platform entry. The presence of new foci will be determined by the site investigator and can incorporate clinical, radiological, microbiological and pathological findings., C. difficile diarrhoea as determined by a clinical laboratory in the 90 days following platform entry for participants ≥2 years of age. This means a stool submitted to a clinical laboratory has tested positive for C. difficile toxin or toxin gene., Serious adverse reactions (SARs) in the 90 days following platform entry., Health economic costs as detailed in the health economics appendix, Proportion of participants who have returned to their usual level of function at day 90 as determined by whether the modified functional bloodstream infection score (FBIS) remained the same or improved between baseline and 90 days after platform entry Baseline=best within the 4 weeks prior to platform entry, Desirability of outcome ranking 1 (modified Antibiotic Resistance Leadership Group version) at 90 days after platform entry, Desirability of outcome ranking 2 (SNAP version) at 90 days after platform entry, Total number of antibiotic days (IV and/or oral/enteral) in the 90 days following platform entry., Days alive and free of antibiotics in the 90 days following platform entry.

Source: https://euclinicaltrials.eu/ctis-public/view/2023-503582-35-00